EU clinical trial 2022-500210-26-00: HYDROchlorothiazide to PROTECT polycystic kidney disease patients and improve their quality of life (HYDRO-PROTECT)
Protocol code: 2022-500210-26-00
Sponsor: University Medical Center Groningen (Hospital/Clinic/Other health care facility). Phase: Therapeutic confirmatory (Phase III). Countries: Spain (ongoing, recruiting), France (ongoing, recruiting), Netherlands (ongoing, recruiting), Belgium (ongoing, recruiting), Germany (ongoing, recruiting), Austria (authorised, recruitment pending).
Therapeutic area(s): Diseases [C] - Congenital, Hereditary, and Neonatal Diseases and Abnormalities [C16]
Gender: Female, Male. Age: 18-64 years, 65+ years. Enrolment: 385.
Start date (EU): 2024-06-28. Decision date: 2023-06-08. Results received: No. Last updated: 2026-07-10.
Decision dates by country: NL: 2023-06-12, AT: 2026-04-27, BE: 2023-06-12, DE: 2023-06-12, ES: 2023-06-09, FR: 2023-11-02

Condition(s): Autosomal Dominant Polycystic Kidney Disease (ADPKD)
Product: HYDROCHLOROTHIAZIDE, Jinarc 30 mg tablets + Jinarc 90 mg tablets, Placebo Role : Placebo Name : Placebo of HYDROCHLOROTHIAZIDE

Primary endpoint: The rate of kidney function decline (expressed as eGFR slope, in mL/min/1.73m2 per year), as calculated by linear mixed model analysis, using all available creatinine values from week 12 until week 156 (EoT) for HCT- versus placebo-treated patients.
Endpoint(s): 1) changes in eGFR between baseline and EoS (off treatment) 2) incidence of a 30% decrease in eGFR, end stage kidney disease or death from renal causes 3) changes in quality of life related questionnaire scores (TIPS, ADPKD-UIS, EQ-5D-5L and SF-12) 4) changes in 24-hour urine volume 5) tolvaptan dose and discontinuation rate 6) changes in serum electrolytes (potassium, sodium, calcium and phosphate) 7) changes in blood pressure

Source: https://euclinicaltrials.eu/ctis-public/view/2022-500210-26-00